EU clinical trial 2024-511090-30-00: DEnosumab for the treatment of FIbrous Dysplasia/McCune-Albright Syndrome in adults (DeFiD): a randomized double-blind placebo-controlled trial
Sponsor: Leids Universitair Medisch Centrum (LUMC) (Hospital/Clinic/Other health care facility). Phase: Phase III and phase IV (Integrated). Countries: Netherlands (ongoing, recruiting).
Therapeutic area(s): Diseases [C] - Musculoskeletal Diseases [C05]
Gender: Female, Male. Age: 18-64 years, 65+ years. Enrolment: 82.
Status: Ongoing, recruiting. Start date (EU): 2023-06-13. Decision date: 2024-04-02. Results received: No. Last updated: 2025-01-27.

Condition(s): Fibrous dysplasia/McCune-Albright syndrome
Product: Sodium Chloride Fresenius Kabi Italia 0.9 % Solution for infusion , DENOSUMAB, Sodium Fluoride (18F) Life Radiopharma 0,1 - 4 GBq/ml solution injectable

Primary endpoint: The effect of Denosumab on pain, assessed by the difference in maximum pain score after 6 months (2 injections) by Brief Pain Inventory
Endpoint(s): To evaluate the effect of Denosumab on average pain scores after 3, 6 months of treatment and in case of open label treatment after 9 and 12 months, To evaluate the number of patients with 50% reduction of maximal pain (BPI) after 3, 6 months of treatment and in case of open label treatment after 9 and 12 months, To evaluate the effect of Denosumab on quality of life, assessed with questionaries (SF-36) at baseline, 3 months and after 6 months and in case of open label treatment after 9 and 12 months, To evaluate the effect of Denosumab on average weekly pain assessed through a pain diary with VAS score, To investigate the effect of Denosumab on Physical activity assessment (Health Assessment Questionnaire – Disability Index and screenshot of pedometer of activity during the last week on smartphone) measured at baseline, 3 months and 6 months, and in case of open label treatment after 9 and 12 months, To evaluate the prevalence of possible neuropathic component of the reported pain through Pain Detect questionnaire at baseline, 3 months and 6 months and in case of open label treatment after 9 and 12 months, To investigate the number of analgesics, use and dosage used at baseline, 3 months and 6 months and in case of open label treatment after 9 and 12 months, To assess the effect of Denosumab on disease activity through laboratory measurements of bone markers at baseline, 3 months and 6 months, and in case of open label treatment after 9 and 12 months, To assess the effect of Denosumab on lesions activity and lesions size through bone scans at baseline and after 6 months, and in the case of open label treatment after 12 months, To assess disease quantification by nuclear imaging before and after treatment (Skeletal Burden Score (SBS), To assess bone density and the presence of vertebral fractures (Dual-energy X-ray absorptiometry (DXA) + Vertebral Fractures Assessment (VFA) at baseline and after 12 months, To assess potential side effects in the form of Atypical femoral fractures by performing and extended DXA after 12 months

Source: https://euclinicaltrials.eu/ctis-public/view/2024-511090-30-00